EU clinical trial 2025-523683-20-00: NoELA_No Endocrine therapy in small HR+ HER2- low relapse risk Luminal A early breast cancer, a single-arm de-escalation trial
Protocol code: UC-BCG-2513
Sponsor: Unicancer (Hospital/Clinic/Other health care facility). Phase: Therapeutic exploratory (Phase II). Countries: France (authorised, recruitment pending).
Therapeutic area(s): Diseases [C] - Neoplasms [C04]
Gender: Female. Age: 18-64 years, 65+ years. Enrolment: 630.
Status: Authorised, recruitment pending. Decision date: 2026-04-21. Results received: No. Last updated: 2026-04-21.

Condition(s): Postmenopausal patients with small (pT1a-b pN0) hormone receptor positive (HR⁺) and HER2 negative (HER2⁻) early breast cancer with a Luminal A phenotype and at low risk of recurrence.
Product: EXEMESTANE, ANASTROZOLE, LETROZOLE, TAMOXIFEN

Primary endpoint: Relapse-free interval (RFI) is defined as the delay between initial treatment and the first occurrence of i) ipsilateral breast tumor recurrence, ii) distant or locoregional recurrence or iii) death from breast cancer, according to the STEEP system definition version 2.0 (Tolaney SM et al., JCO 2021)
Endpoint(s): RFI of participants treated with adjuvant hormone therapy in the CANTO study, Incidence of Ipsilateral DCIS, Contralateral DCIS, Invasive contralateral breast cancer at 5, 8 and 10 years*, Distant disease free survival (DDFS) and relapse free survival (RFS) rates at 5, 8, 10 years and overall survival (OS) at 5, 10 years * (RFI, DDFS, RFS and OS defined as per standardized STEEP v2.0 criteria), EORTC QLQC30 and EORTC QLQ-BR42, HADS questionnaires, Bone-related events and osteopenia/osteoporosis diagnosis, dyslipidemia (hypercholesterolemia and hypertriglyceridemia) and cardiovascular events (myocardial infarction, stroke, and thromboembolic events), as per CTCAE v6.0.

Source: https://euclinicaltrials.eu/ctis-public/view/2025-523683-20-00